EU clinical trial 2024-513799-16-00: Acetazolamide in combination with SGLT2i in patients with volume overload and acute heart failure
Sponsor: Ziekenhuis Oost Limburg (Hospital/Clinic/Other health care facility). Phase: Therapeutic use (Phase IV). Countries: Belgium (authorised, recruitment pending).
Therapeutic area(s): Diseases [C] - Cardiovascular Diseases [C14]
Gender: Female, Male. Age: 18-64 years, 65+ years. Enrolment: 30.
Status: Authorised, recruitment pending. Decision date: 2025-01-15. Results received: No. Last updated: 2025-01-15.

Condition(s): Acute Heart Failure
Product: Jardiance 10 mg film-coated tablets, Forxiga 10 mg film-coated tablets, DIAMOX parenteraal 500 mg poeder voor injectievloeistof

Primary endpoint: 24-hour sodium excretion
Endpoint(s): 24-hour volume output, Weight change, Congestion assessment according to the ADVOR protocol, Plasma volume changes, Changes in neurohormonal stimulation (renin, aldosterone), Changes in POCUS (Heart, IVC, lung, abdomen, JVP)

Source: https://euclinicaltrials.eu/ctis-public/view/2024-513799-16-00